EU clinical trial 2024-518509-17-00: A multicentre study evaluating the safety of reperfusion thrombolytic therapy with intravenous recombinant tissue plasminogen activator (rtPA) for ischaemic stroke in patients on the non-vitamin K antagonist oral anticoagulant after reversing anticoagulant activity with a specific antidote.
Protocol code: NBK241/1/2020
Sponsor: Medical University Of Gdansk (Educational Institution). Phase: Therapeutic exploratory (Phase II). Countries: Poland (ongoing, recruiting).
Therapeutic area(s): Diseases [C] - Nervous System Diseases [C10]
Gender: Female, Male. Age: 18-64 years, 65+ years. Enrolment: 215.
Status: Ongoing, recruiting. Start date (EU): 2022-01-10. Decision date: 2024-12-09. Results received: No. Last updated: 2026-03-07.

Condition(s): Acute ischemic stroke
Product: Actilyse 50, 50 mg, proszek i rozpuszczalnik do sporządzania roztworu do infuzji, Actilyse 20, 20 mg, proszek i rozpuszczalnik do sporządzania roztworu do infuzji, Ondexxya 200 mg powder for solution for infusion, Actilyse 10, 10 mg, proszek i rozpuszczalnik do sporządzania roztworu do infuzji

Primary endpoint: PRIMARY ENDPOINTS – INTERVENTIONAL PART OF THE STROACT STUDY: 1. The occurrence of thrombotic events and death (1- yes, 0-no)., PRIMARY ENDPOINTS – OBSERVATIONAL PART OF THE STROACT STUDY: 1. Outcome in mRS at 90 days (the proportion of patients with AIS with excellent or good functional outcome assessed with modified Rankin scale (mRS), mRS 0-1 and 0-2 respectively) at 90 days (+/- 3 days) after the admission.
Endpoint(s): SECONDARY END POINTS – ONLY INTERVENTIONAL PART OF THE STROACT STUDY: a) Efficacy: mRS at 90 days - the proportion of patients with AIS with excellent or good functional outcome assessed with modified Rankin scale (mRS)., SECONDARY END POINTS – ONLY INTERVENTIONAL PART OF THE STROACT STUDY: b) Efficacy: Change in NIHSS score from baseline assessed at 7 (+/-1 day) after investigational treatment administration., Safety – only interventional part of the STROACT study: a) Incidence of deaths: - Deaths from any cause - Deaths subdivided by cause at 7 (+/-1 day), 30 (+/-2 days) and 90 days (+/ 3 days) after treatment administration., Safety – only interventional part of the STROACT study: b) Incidence of non-fatal events defined as - Recurrent ischaemic stroke - Haemorrhagic stroke (ICH or SAH) - Neurological deterioration (NIHSS) at 7 (+/-1 day) and 90 days (+/- 3 days) after treatment administration., Safety – only interventional part of the STROACT study: c) Rate and severity of early (symptomatic and asymptomatic) intracranial haemorrhage detected by neuroimaging: - CT or MRI at 24hrs (+/- 4hrs) after investigational treatment administration - CT or MRI at 7 days (+/- 1 day) after investigational treatment infusion and assessed according to European Cooperative Acute Stroke Study (ECASS II) classification., Safety – only interventional part of the STROACT study: d) Incidence and severity of major extracranial haemorrhages defined as: - fatal - severe enough to require transfusion or surgery - an absolute decrease in haemoglobin > 5 g/dL - a decrease in haematocrit of > 15% - leading to in persistent or temporary serious disability., Safety – only interventional part of the STROACT study: e) Incidence and category of AEs reported during the study.

Source: https://euclinicaltrials.eu/ctis-public/view/2024-518509-17-00